EU clinical trial 2025-524259-30-00: AMOXICILLIN VERSUS AMOXICILLIN-CLAVULANATE VERSUS PLACEBO IN ACUTE OTITIS MEDIA IN CHILDREN – A PARALLEL-GROUP TRIPLE-BLINDED RANDOMIZED CONTROLLED SUPERIORITY TRIAL
Protocol code: SAVOtitis trial
Sponsor: Pohjois-Savon hyvinvointialue (Patient organisation/association). Phase: Phase III and phase IV (Integrated). Countries: Finland (authorised, recruitment pending).
Therapeutic area(s): Diseases [C] - Bacterial Infections and Mycoses [C01]
Gender: Female, Male. Age: 0-17 years. Enrolment: 219.
Status: Authorised, recruitment pending. Decision date: 2026-02-17. Results received: No. Last updated: 2026-06-11.
Decision dates by country: FI: 2026-02-19

Condition(s): Acute otitis media
Product: SyrsSpend SF pH 4, Amorion Comp 80 mg/ml jauhe oraalisuspensiota varten, Amorion 100 mg/ml jauhe oraalisuspensiota varten

Primary endpoint: The primary outcome is condition of the child, measured daily in days 1-7 and at days 10 and 14 with AOM-SOS score version 6.0. The treatment effectiveness measured as risk ratios and generalized estimation equations (GEE) are used to convert the daily mean comparisons into relative effect estimates
Endpoint(s): Secondary outcomes are proportions of children - needing rescue antibiotics - with no improvement of overall condition by the first scheduled control visit (day 2-4) - with no improvement of otoscopic signs (7-9 day visit) - with middle ear effusion at days 2, 7 and 14 - with development of contralateral AOM during the treatment - with spontaneous perforation of the tympanic membrane during the treatment - with side effects (for ex. diarrhea, rash)

Source: https://euclinicaltrials.eu/ctis-public/view/2025-524259-30-00